EU clinical trial 2024-510856-11-00: A study to learn more about how BAY3283142 moves into, through, and out of the body of healthy participants when taken together with atazanavir and to assess the proportion of BAY3283142 that reaches the blood when taken by mouth.
Protocol code: 22128
Sponsor: Bayer AG (Pharmaceutical company). Phase: Human Pharmacology (Phase I)- Other. Countries: Netherlands (ended).
Therapeutic area(s): Diseases [C] - Cardiovascular Diseases [C14]
Gender: Female, Male. Age: 18-64 years. Enrolment: 15.
Status: Ended. Start date (EU): 2024-10-31. End date (EU): 2025-04-01. Decision date: 2024-07-19. Results received: No. Last updated: 2025-01-21.

Condition(s): Chronic kidney disease

Source: https://euclinicaltrials.eu/ctis-public/view/2024-510856-11-00